EU clinical trial 2022-503128-29-00: Multi-centre, Open-label Trial to Assess the SaFety, Pharmacodynamics, Efficacy and Pharmacokinetics of PegunigaLsidase Alfa in Patients from 2 Years to Less Than 18 Years of Age with Confirmed FabrY Disease (FLY)
Protocol code: CLI-06657AA1-01
Sponsor: Chiesi Farmaceutici S.p.A. (Pharmaceutical company). Phase: Phase II and Phase III (Integrated). Countries: France (authorised, recruiting), Spain (authorised, recruiting), Norway (ongoing, recruiting), Austria (authorised, recruiting).
Therapeutic area(s): Diseases [C] - Congenital, Hereditary, and Neonatal Diseases and Abnormalities [C16]
Gender: Female, Male. Age: 0-17 years. Enrolment: 7.
Start date (EU): 2024-10-08. Decision date: 2024-09-16. Results received: No. Last updated: 2026-06-24.
Decision dates by country: NO: 2024-09-19, ES: 2024-09-17, AT: 2024-09-20, FR: 2024-09-16

Condition(s): Fabry's disease

Primary endpoint: Safety Variables: •Treatment-emergent adverse events (TEAEs) • Infusion-related reactions (IRRs) • Injection site reactions (ISRs), Safety Variables: • Clinical laboratory tests • Physical examination • Vital signs • Electrocardiogram (ECG) • Assessment for the development of anti-drug antibodies (ADA) against PRX-102 • Use of pre-medications to manage infusion-related reactions • Growth and development (height, weight, and sexual development by Tanner staging), Efficacy Variables: Renal function: • eGFR, calculated using the Creatinine-Cystatin C–based Chronic Kidney Disease in Children (CKiD) (2012). •Albuminuria, as determined by the urine albumin-to-creatinine ratio (uACR) test, and proteinuria, as determined by the urine protein-to-creatinine ratio (UPCR) test., Efficacy Variables: Cardiac function: • Echocardiogram • Holter ECG • Cardiac biomarkers: • High-sensitivity cardiac troponin T (hs-cTnT) • N-terminal pro B-type natriuretic peptide (NT-proBNP), Fabry disease biomarkers: • Plasma globotriaosylceramide (Gb3) concentration •Plasma globotriaosylsphingosine (lyso-Gb3) concentration • Urine lyso-Gb3 concentration, Other measures of Fabry disease: • Use of pain medications • Occurrence of Fabry clinical events (FCEs) • Mainz Severity Score Index (MSSI) • Paediatric Quality of Life Inventory -Gastrointestinal Symptoms (PedsQL-GI) questionnaire: parent version and age- appropriate subject version, Other measures of Fabry disease: • Fabry Specific Pediatric Health and Pain Questionnaire (FPHPQ): age appropriate subject version • Paediatric Quality of Life Inventory - Pain Questionnaire (PedsQL-PPQ): parent version and age- appropriate subject version, Other measures of Fabry disease: • EuroQoL 5 Dimensions version for youth (EQ-5D-Y) questionnaire for assessment of quality of life: parent version and age- age-appropriate subject version, Measures to be used if a subject reaches the age of 18 years: • Gastrointestinal Symptom Rating Scale (GSRS) in place of the PedsQL-GI • Brief Pain Inventory - Short Form (BPI-SF) in place of the PedsQL-PPQ, Measures to be used if a subject reaches the age of 18 years: • Quality-of-life EuroQoL 5 Dimensions 5 Levels Questionnaires (EQ-5D-5L) questionnaire in place of the EQ-5D-Y • In addition, the FPHPQ will be dropped. The other measures (use of pain medications, occurrence of FCEs, and completion of the MSSI) will remain the same, Pharmacokinetic Assessments: • The individual PK parameters and their relationship with PD and/or efficacy endpoints (e.g., with plasma lyso-Gb3 and/or any other relevant PD and/or efficacy endpoints) will be derived from the updated population PK model after the addition of the emerging data., Pharmacodynamic Assessments: Fabry disease is characterised by the progressive accumulation of Gb3 and its metabolite lyso-Gb3, so concentrations of Gb3 and lyso-Gb3 are biomarkers of the extent of the disease., Pharmacodynamic Assessments: For purposes of determining the dosages of PRX-102 to be used in Stage II for Cohorts A and B, blood samples and urine samples for measuring the concentration of Gb3 and lyso-Gb3 will be collected in Stage I E2W at Visits #1, #3, #7 and #14., Pharmacodynamic Assessments: For purposes of determining the dosages of PRX-102 to be used in Stage II for Cohorts A and B, blood samples and urine samples for measuring the concentration of Gb3 and lyso-Gb3 will be collected in Stage I E2W at Visits #1, #3, #7 and #14., Pharmacodynamic Assessments: For purpose of assessing efficacy, additional blood samples for the measurement of Gb3 and lyso-Gb3 and urine samples for the measurement of lyso-Gb3 will be collected at specified time points during the study in all cohorts.

Source: https://euclinicaltrials.eu/ctis-public/view/2022-503128-29-00